EU clinical trial 2022-502980-39-00: A Phase III, Randomized, Open-Label Study Evaluating Efficacy and Safety of Giredestrant Compared with Fulvestrant, both Combined with a CDK4/6 Inhibitor, in Patients with Estrogen Receptor-Positive, HER2-Negative Advanced Breast Cancer with Resistance to Prior Adjuvant Endocrine Therapy
Protocol code: CO44657
Sponsor: F. Hoffmann-La Roche AG (Pharmaceutical company). Phase: Therapeutic confirmatory (Phase III). Countries: Slovenia (ongoing, recruitment ended), Finland (ongoing, recruitment ended), Belgium (ongoing, recruitment ended), Germany (ongoing, recruitment ended), France (ongoing, recruitment ended), Greece (ongoing, recruitment ended), Spain (ongoing, recruitment ended), Romania (ongoing, recruitment ended), Portugal (ongoing, recruitment ended), Hungary (ongoing, recruitment ended), Italy (ongoing, recruitment ended), Poland (ongoing, recruitment ended), Austria (ongoing, recruitment ended).
Therapeutic area(s): Diseases [C] - Neoplasms [C04]
Gender: Female, Male. Age: 18-64 years, 65+ years. Enrolment: 296.
Status: Ongoing, recruitment ended. Start date (EU): 2024-01-25. Decision date: 2024-01-16. Results received: No. Last updated: 2026-06-12.
Decision dates by country: AT: 2024-01-22, GR: 2024-01-22, HU: 2024-01-17, SI: 2024-01-16, PL: 2024-01-19, PT: 2024-01-19, BE: 2024-01-16, FI: 2024-01-17, RO: 2024-01-22, IT: 2024-01-18, DE: 2024-01-16, FR: 2024-01-18, ES: 2024-01-22

Condition(s): Estrogen receptor (ER)-positive, HER2-negative advanced breast cancer
Product: Verzenios 150 mg film-coated tablets, IBRANCE 75 mg film-coated tablets, LEUPRORELIN, IBRANCE 100 mg film-coated tablets, Verzenios 50 mg film-coated tablets, RIBOCICLIB, RO7197597, IBRANCE 125 mg film-coated tablets, Verzenios 100 mg film-coated tablets, Faslodex 250 mg solution for injection., Kisqali 200 mg film-coated tablets

Primary endpoint: 1. Progression-Free Survival (PFS), defined as time from randomization to first occurrence of disease progression (PD), as determined by the investigator according to RECIST v1.1, or death from any cause during the study (whichever occurs first), in the ESR1m subgroup and in the FAS
Endpoint(s): 1. PFS in the ESR1nmd subgroup, 2. OS, defined as the time from randomization to death from any cause, 3. cORR, defined as the proportion of participants with a complete response (CR) or partial response (PR) on two consecutive occasions ≥ 4 weeks apart, as determined by the investigator according to RECIST v1.1, 4. DOR, defined as the time from the first occurrence of a documented objective response to PD, as determined by the investigator according to RECIST v1.1, or death from any cause (whichever occurs first), 5. CBR, defined as the proportion of participants with stable disease for ≥ 24 weeks or a CR or PR, as determined by the investigator according to RECIST v1.1, 6. TTCtx, defined as the time from randomization until the start date of chemotherapy or death from any cause (whichever occurs first), 7. TTCD in pain severity, defined as the time from randomization to the first documentation of a ≥ 2-point increase from baseline on the “worst pain” item score from the BPI-SF, 8. TTCD in pain presence and interference, defined as the time from randomization to the first documentation of a ≥ 10-point increase from baseline in the EORTC QLQ-C30 linearly transformed pain scale score, 9. TTCD in PF, RF and GHS/QoL, defined as the time from randomization to the first documentation of a ≥ 10-point decrease from baseline in the EORTC QLQ-C30 linearly transformed respective scale scores, 10. Incidence and severity of adverse events, with severity determined according to NCI CTCAE v5.0, 11. Change from baseline in selected vital signs, 12. Change from baseline in selected clinical laboratory test results

Source: https://euclinicaltrials.eu/ctis-public/view/2022-502980-39-00